EU clinical trial 2025-522798-13-00: Sodium selenite in patients with advanced carcinoma: A phase I/II study with 99 hours of continuous selenite treatment followed by chemotherapy
Protocol code: SECAR 1c
Sponsor: Karolinska University Hospital (Hospital/Clinic/Other health care facility). Phase: Phase I and Phase II (Integrated)- Other. Countries: Sweden (ongoing, recruiting).
Therapeutic area(s): Diseases [C] - Neoplasms [C04]
Gender: Female, Male. Age: 18-64 years, 65+ years. Enrolment: 25.
Status: Ongoing, recruiting. Start date (EU): 2026-04-17. Decision date: 2025-12-17. Results received: No. Last updated: 2025-12-17.

Condition(s): Advanced carcinoma
Product: selesyn 500 micrograms/10 ml, solution for injection (50 micrograms/ml)

Primary endpoint: The optimal dose, i.e., the dose with the best clinical response without DLT. Clinical response will be evaluated using RECIST 1.1 on CT scans taken before and after the selenite treatment. Toxicity will be measured according to the CTCAE V4.0 system (as in previous SECAR studies, to allow for direct comparisons).
Endpoint(s): Tumor response to chemotherapy following selenite treatment as evaluated using RECIST 1.1 on CT scans taken before and after chemotherapy., Improvement of disease symptoms as measured by improvement in WHO performance status assessed before, during and after treatments, Improvement of disease symptoms according to tumour markers or improvement of other abnormal laboratory results measured before, during and after treatments., Description of the pharmacokinetics of selenium and selenite. Plasma, erythrocytes and urine for these analyses will be collected before, during and after the selenite infusion., Correlation between plasma levels and erythrocyte levels of selenite and clinical responses and AE’s., The effect of high dose selenite-infusion on immunological variables, Overall survival as measured from the first selenite treatment day until death of any cause.

Source: https://euclinicaltrials.eu/ctis-public/view/2025-522798-13-00